EU clinical trial 2024-512884-30-00: A randomized phase III study comparing trastuzumab, pertuzumab plus docetaxel (TPD) followed by 3 cycles of chemotherapy to the current standard regimen as the treatments of early HER2-positive breast cancer
Protocol code: FBCSG-01-2007
Sponsor: HUS-Yhtymae (Hospital/Clinic/Other health care facility). Phase: Therapeutic confirmatory (Phase III). Countries: Sweden (authorised, recruitment pending), Finland (authorised, recruitment pending).
Therapeutic area(s): Diseases [C] - Neoplasms [C04]
Gender: Female. Age: 18-64 years, 65+ years. Enrolment: 520.
Status: Authorised, recruitment pending. Decision date: 2024-04-25. Results received: No. Last updated: 2024-04-25.
Decision dates by country: FI: 2024-04-25, SE: 2024-04-25

Condition(s): breast cancer
Product: Perjeta 420 mg concentrate for solution for infusion, PERTUZUMAB

Primary endpoint: Invasive disease-free survival
Endpoint(s): Overall survival; Distant disease-free survival; Left ventricle ejection fractions; Adverse event rate; Quality of life

Source: https://euclinicaltrials.eu/ctis-public/view/2024-512884-30-00